EU clinical trial 2023-506192-10-00: Quantitative Fluorescence molecular imaging in Crohn’s disease and psoriasis
Sponsor: University Medical Center Groningen (Hospital/Clinic/Other health care facility). Phase: Human Pharmacology (Phase I)- First administration to humans. Countries: Netherlands (ongoing, recruiting).
Therapeutic area(s): Diseases [C] - Immune System Diseases [C20]
Gender: Female, Male. Age: 18-64 years, 65+ years. Enrolment: 56.
Status: Ongoing, recruiting. Start date (EU): 2025-02-14. Decision date: 2024-10-24. Results received: No. Last updated: 2025-09-01.

Condition(s): Crohn's disease, Psoriasis

Source: https://euclinicaltrials.eu/ctis-public/view/2023-506192-10-00